EU clinical trial 2024-511215-21-00: Trial of the novel peroral anti-tumor treatment in patients with solid tumors
Protocol code: TU31-KH1
Sponsor: VUAB Pharma a.s. (Pharmaceutical company). Phase: Human Pharmacology (Phase I)- First administration to humans. Countries: Czechia (ongoing, recruiting).
Therapeutic area(s): Diseases [C] - Neoplasms [C04]
Gender: Female, Male. Age: 18-64 years, 65+ years. Enrolment: 30.
Status: Ongoing, recruiting. Start date (EU): 2022-06-07. Decision date: 2024-09-09. Results received: No. Last updated: 2026-07-14.

Condition(s): Metastatic or locally advanced solid tumors for which no standard therapy exists or standard therapy has failed: tumors of lung, head and neck, colon, stomach, esophagus, breast, ovary and/or fallopian tube or primary peritoneal high-grade serous carcinoma

Source: https://euclinicaltrials.eu/ctis-public/view/2024-511215-21-00